EU clinical trial 2024-517449-14-00: A phase I/II trial of IOMX-0675 a fully human monoclonal antibody selectively inhibiting LILRB1/2 alone or in combination with pembrolizumab in patients with previously treated advanced/metastatic solid tumors (LIMNOS)
Sponsor: iOmx Therapeutics AG (Pharmaceutical company). Phase: Human Pharmacology (Phase I)- First administration to humans. Countries: Spain (authorised, recruitment pending).
Therapeutic area(s): Diseases [C] - Neoplasms [C04]
Gender: Female, Male. Age: 18-64 years, 65+ years. Enrolment: 110.
Status: Authorised, recruitment pending. Decision date: 2025-04-03. Results received: No. Last updated: 2025-04-03.

Condition(s): Advanced/metastatic solid tumors
Product: KEYTRUDA 25 mg/mL concentrate for solution for infusion

Primary endpoint: Identification of a RP2D and combination dose of IOMX-0675 based on the comparative integration of this information across dose levels:, • Incidence of DLTs attributable to IOMX-0675 and pembrolizumab, where applicable, at each dose level and identification of a maximum tolerated dose (MTD)., • Type, incidence, and severity of treatment related AEs according to the NCI CTCAE version 5.0 at each dose level., • Calculation of at least the following parameters: Cmax, tmax, AUClast, t½ from concentration time information., • Maximum receptor occupancy, Dose selection will be further supported by:, • Observed clinical activity (see secondary endpoints), • Biomarker activity
Endpoint(s): Overall response rate (ORR), Duration of Response (DoR), Progression free survival (PFS)

Source: https://euclinicaltrials.eu/ctis-public/view/2024-517449-14-00